EU clinical trial 2025-521096-31-00: An Evaluation of Bemnifosbuvir-Ruzasvir (BEM/RZR) Versus Sofosbuvir-Velpatasvir (SOF/VEL) for the Treatment of Chronic Hepatitis C Virus (HCV) Infection in a Phase 3 Randomized, Controlled, Open-label Study
Protocol code: AT-01B-008
Sponsor: Atea Pharmaceuticals Inc. (Pharmaceutical company). Phase: Therapeutic confirmatory (Phase III). Countries: Romania (ongoing, recruitment ended), France (ongoing, recruitment ended), Germany (ongoing, recruitment ended), Greece (ongoing, recruitment ended), Poland (ongoing, recruitment ended), Spain (ongoing, recruitment ended).
Therapeutic area(s): Diseases [C] - Virus Diseases [C02]
Gender: Female, Male. Age: 18-64 years, 65+ years. Enrolment: 275.
Status: Ongoing, recruitment ended. Start date (EU): 2025-10-02. Decision date: 2025-09-08. Results received: No. Last updated: 2026-07-20.
Decision dates by country: GR: 2025-09-16, PL: 2025-09-19, FR: 2025-09-10, DE: 2025-09-08, RO: 2025-09-10, ES: 2025-09-09

Condition(s): Chronic Hepatitis C Virus (HCV) Infection
Product: Sofosbuvir / Velpatasvir, Bemnifosbuvir/Ruzasvir Fixed Dose Combination (FDC)

Primary endpoint: Proportion of subjects achieving HCV RNA less than the lower limit of quantitation (LLOQ) at study week 24.
Endpoint(s): Proportion of subjects achieving HCV RNA < LLOQ 12 weeks after the last dose of study drugs., Proportion of subjects experiencing virologic failure.

Source: https://euclinicaltrials.eu/ctis-public/view/2025-521096-31-00